EU clinical trial 2023-510306-40-00: A Randomized Phase 2 Study of Erdafitinib Versus Investigator Choice of Intravesical Chemotherapy in Subjects Who Received Bacillus Calmette-Guérin (BCG) and Recurred With High Risk Non-Muscle-Invasive Bladder Cancer (NMIBC) and FGFR Mutations or Fusions
Protocol code: 42756493BLC2003
Sponsor: Janssen Cilag International (Pharmaceutical company). Phase: Therapeutic exploratory (Phase II). Countries: France (ended), Germany (ended), Poland (ended).
Therapeutic area(s): Diseases [C] - Neoplasms [C04]
Gender: Female, Male. Age: 18-64 years, 65+ years. Enrolment: 6.
Status: Ended. Start date (EU): 2020-08-11. End date (EU): 2025-02-27. End date: 2025-02-28. Decision date: 2024-05-13. Results received: Yes. Last updated: 2025-01-22.
Decision dates by country: FR: 2024-06-11, PL: 2024-05-16, DE: 2024-05-13

Condition(s): Cohort 1 and 2: High Risk Non-Muscle-Invasive Bladder Cancer (NMIBC) with FGFR Mutations or Fusions; Cohort 3 Intermediate Risk Non-Muscle-Invasive Bladder Cancer (NMIBC) with FGFR Mutations or Fusions
Product: Gemcitabine 38 mg/ml Concentrate for Solution for Infusion, JNJ-42756493, Gemcitabine 2 g Powder for Solution for Infusion, JNJ-42756493, JNJ-42756493, Mitomycin medac 1 mg/ml Pulver zur Herstellung einer Injektions- bzw. Infusionslösung oder einer Lösung zur intravesikalen Anwendung

Primary endpoint: Recurrence-free survival (RFS)

Source: https://euclinicaltrials.eu/ctis-public/view/2023-510306-40-00